EU clinical trial 2024-518577-34-00: (A)nalysis of immunological (VA)riables in ex vivo (T)ofacitinib-treated human biopsies from (A)ctive ulcerative colitis patients to predict clinical (R)esponse (the AVATAR study).
Sponsor: Universita' Degli Studi Di Roma Tor Vergata (Educational Institution). Phase: Therapeutic use (Phase IV). Countries: Italy (ended).
Therapeutic area(s): Diseases [C] - Immune System Diseases [C20]
Gender: Female, Male. Age: 18-64 years, 65+ years. Enrolment: 60.
Status: Ended. Start date (EU): 2021-12-16. End date (EU): 2025-05-06. Decision date: 2024-11-19. Results received: Yes. Last updated: 2024-11-19.

Condition(s): Ulcerative colitis
Product: XELJANZ 10 mg film-coated tablets

Primary endpoint: Immunological characterization

Source: https://euclinicaltrials.eu/ctis-public/view/2024-518577-34-00